EU clinical trial 2024-517310-15-00: A multi-part study to investigate MTX325 in healthy volunteers and patients with Parkinson's Disease
Protocol code: MTX325-101
Sponsor: Mission Therapeutics Limited (Pharmaceutical company). Phase: Human Pharmacology (Phase I)- Other. Countries: Germany (authorised, recruitment pending), Netherlands (authorised, recruitment pending), France (authorised, recruitment pending).
Therapeutic area(s): Diseases [C] - Nervous System Diseases [C10]
Gender: Female, Male. Age: 18-64 years, 65+ years. Enrolment: 18.
Status: Authorised, recruitment pending. Decision date: 2026-05-18. Results received: No. Last updated: 2026-05-22.
Decision dates by country: DE: 2026-05-19, NL: 2026-05-22, FR: 2026-05-18

Condition(s): Parkinson's Disease

Source: https://euclinicaltrials.eu/ctis-public/view/2024-517310-15-00